EU clinical trial 2025-522845-23-00: An open-label, non-randomized, single center, single dose, exploratory phase II trial of FG001 (an imaging agent) in combination with transoral robotic surgery for oropharyngeal squamous cell carcinoma and neck dissection surgery for oral squamous cell carcinoma with regional lymph node metastases
Protocol code: RH-FG001-02
Sponsor: Rigshospitalet (Hospital/Clinic/Other health care facility). Phase: Therapeutic exploratory (Phase II). Countries: Denmark (authorised, recruitment pending).
Therapeutic area(s): Diseases [C] - Neoplasms [C04]
Gender: Female, Male. Age: 18-64 years, 65+ years. Enrolment: 40.
Status: Authorised, recruitment pending. Decision date: 2026-06-08. Results received: No. Last updated: 2026-06-08.

Condition(s): Oral Squamous Cell Carcinoma with neck metastases, Oropharyngeal Squamous Cell Carcinoma
Product: FG001

Primary endpoint: OPSCC cohort: Sensitivity of FG001 for detection of primary OPSCC during TORS, using histopathology of the resected primary tumor specimen as reference standard., OSCC cohort: Node-level sensitivity of FG001 for detection of metastatic lymph nodes, using lymph node histopathology as reference standard.
Endpoint(s): OPSCC cohort: Tumor-to-background ratio (TBR_mean and TBR_max) calculated from selected fluorescence images comparing tumor Region of interest (ROI) and adjacent non-tumor tissue., OPSCC cohort: Residual fluorescence in the resection cavity after completion of planned resection (present/absent) will be recorded together with residual disease status based on histopathology of fluorescence-targeted fresh-frozen-section biopsies., OSCC cohort: Node-level specificity, PPV, and NPV for metastatic lymph node detection; Receiver operating characteristic (ROC) analysis (as applicable), using lymph node histopathology as reference standard., OSCC cohort: Signal-to-background ratio (SBR) and fluorescence intensity of dissected lymph nodes calculated from selected fluorescence images using signal ROI and adjacent tissue

Source: https://euclinicaltrials.eu/ctis-public/view/2025-522845-23-00